EU clinical trial 2024-511754-41-00: A Phase 2, Multi-Center, Randomized, Double-Blind, Controlled Trial Evaluating the Safety and Efficacy of ENV-101 in Patients with Lung Fibrosis (WHISTLE-PF Trial)
Protocol code: ENV-IPF-103
Sponsor: Endeavor Biomedicines Inc. (Pharmaceutical company). Phase: Therapeutic exploratory (Phase II). Countries: Belgium (ongoing, recruitment ended), Ireland (ongoing, recruitment ended), Germany (ongoing, recruitment ended), Italy (ongoing, recruitment ended), Austria (ended), France (ongoing, recruitment ended).
Therapeutic area(s): Diseases [C] - Neoplasms [C04]
Gender: Female, Male. Age: 18-64 years, 65+ years. Enrolment: 140.
Start date (EU): 2025-05-29. Decision date: 2025-03-03. Results received: No. Last updated: 2026-08-08.
Decision dates by country: DE: 2025-03-04, FR: 2025-06-04, AT: 2025-03-10, IE: 2025-03-07, BE: 2025-03-03, IT: 2025-03-07

Condition(s): idiopathic pulmonary fibrosis
Product: Taladegib, Taladegib, Placebo drug product is available as a film-coated tablet containing no taladegib. the dosage form is provided as equivalent in size, color and shape to the active 100 mg oval-shaped, convex, aquamarine-colored tablets., Placebo drug product is available as a film-coated tablet containing no taladegib. The dosage form is provided as equivalent in size, color and shape to the active 25 mg oval-shaped, convex, aquamarine-colored tablets.

Primary endpoint: Change in ppFVC from baseline to Week 24, as compared to PBO.
Endpoint(s): Absolute change in FVC (mL) from baseline to Week 24, as compared to PBO., Time to disease progression (absolute decline in ppFVC >10%, IPF related hospitalization, or death) up to Week 24, as compared to PBO., Absolute change in L-PF Symptoms Cough domain score from baseline to Week 24, as compared to PBO., Absolute change in L-PF Symptoms Dyspnea domain score from baseline to Week 24, as compared to PBO., Absolute change in L-PF Symptoms Fatigue domain score from baseline to Week 24, as compared to PBO

Source: https://euclinicaltrials.eu/ctis-public/view/2024-511754-41-00